EU clinical trial 2023-503267-42-00: RAINBO: Refining Adjuvant treatment IN endometrial cancer Based On molecular features, TransPORTEC platform trials (MMRd-GREEN)
Protocol code: RAINBO MMRd-GREEN
Sponsor: Leiden University Medical Center (Hospital/Clinic/Other health care facility). Phase: Therapeutic confirmatory (Phase III). Countries: Netherlands (ongoing, recruiting), Belgium (ongoing, recruiting), Czechia (ongoing, recruiting), France (ongoing, recruiting), Germany (ongoing, recruiting), Italy (ongoing, recruiting).
Therapeutic area(s): Diseases [C] - Neoplasms [C04]
Gender: Female. Age: 18-64 years, 65+ years. Enrolment: 362.
Status: Ongoing, recruiting. Start date (EU): 2022-06-10. Decision date: 2023-05-04. Results received: No. Last updated: 2026-07-15.
Decision dates by country: NL: 2023-05-04, DE: 2023-11-22, FR: 2023-11-16, CZ: 2023-12-06, BE: 2023-11-22, IT: 2024-06-10

Condition(s): Patients with a histological diagnosis of mismatch- repair deficient high risk endometrial cancer (MMRd HREC; no POLEmut; all histology including carcinosarcoma), Stage IB/II with LVSI or stage IIIA-C. Patients are treated with curative intent, after surgery (hysterectomy and bilateralsalpingo-oophorectomy, with or without lymphadenectomy or sentinel node biopsy), without signs of residual disease or distant metastases.
Product: IMFINZI 50 mg/mL concentrate for solution for infusion.

Primary endpoint: 3 year recurrence free survival (RFS) in patients with MMRd EC. RFS is defined as time from randomization until date of any recurrence (local or distant) or date of death due to any cause.
Endpoint(s): Investigator assessed 5 yr RFS, OS (median, 3yr, 5yr), Vaginal RFS, pelvic RFS, distant metastasis free-survival (median, 3-year, 5-year), Disease-specific survival (median, 3-year, 5-year), HRQoL (EORTC QLQC30 and EORTC QLQEN24), Safety & tolerability, grade 3-5 according to NCI-CTC version 5.0., Exploratory TR, including PD-L1 testing using SP263 assay and TIP algorithm (>1% and 5%) on biopsy or resections of ECsamples

Source: https://euclinicaltrials.eu/ctis-public/view/2023-503267-42-00